EU clinical trial 2025-522323-10-00: Prevention and Treatment of Episodic migraine by Cabergoline Therapy (PROTECT) A randomized, placebo-controlled, double-blind, investigator-initiated trial
Sponsor: Region Midtjylland (Hospital/Clinic/Other health care facility). Phase: Therapeutic confirmatory (Phase III). Countries: Denmark (authorised, recruiting).
Therapeutic area(s): Diseases [C] - Nervous System Diseases [C10]
Gender: Female, Male. Age: 18-64 years, 65+ years. Enrolment: 150.
Status: Authorised, recruiting. Start date (EU): 2025-11-12. Decision date: 2025-11-07. Results received: No. Last updated: 2025-12-09.

Condition(s): Migraine
Product: Placebo for cabergoline capsules 0.5 mg and 1.0 mg, Dostinex, tabletter

Primary endpoint: Change in MMD from baseline to the end of the 12-week double-blind phase. Migraine days are defined according to ICHD-3 criteria or the use of migraine-specific acute medication, recorded in a daily, electronic diary.
Endpoint(s): Change in MMD from baseline to the last four weeks of the double-blind treatment phase., Proportion of participants achieving ≥50% reduction in MMD during the last four weeks of the 12-week double-blind treatment phase., Change in number of moderate/severe headache days from baseline to the last four weeks of the double-blind treatment phase., Proportion of attacks classified as mild, moderate, or severe at the last four weeks of the double-blind treatment phase., Change in number of days with use of acute migraine-specific medication from baseline to the last four weeks of the double-blind treatment phase., Change in MIDAS, HIT-6 and WPAI scores from baseline to the last four weeks of the double-blind treatment phase., PGIC score at the end of the double-blind treatment phases., Change in MMD, proportion of participants achieving ≥50% reduction in MMD, number of moderate/severe headache days, acute medication use, and patient-reported outcomes (HIT-6, MIDAS, WPAI, and PGIC) assessed from baseline and from the last four weeks of the double-blind phase to the last four weeks of the open-label phase., Change in MMD, proportion of participants achieving ≥50% reduction in MMD, number of moderate/severe headache days, acute medication use, and patient-reported outcomes (HIT-6, MIDAS, WPAI, and PGIC) from baseline to the last four weeks of the double-blind phase., Change in MMD, proportion of participants achieving ≥50% reduction in MMD, number of moderate/severe headache days, acute medication use, and patient-reported outcomes (HIT-6, MIDAS, WPAI, and PGIC) from baseline to the last four weeks of the double-blind phase., Incidence, severity, and type of AEs and SAEs during the trial., Change in LDL-C, HDL-C, total cholesterol, triglycerides, HbA1c, FSH, LH, estrogen/testosterone, and hs-CRP from baseline to the end of the double-blind and open-label treatment phases., Change in serum prolactin levels from baseline to the end of the double-blind and open-label treatment phases., Genotyping of all participants for variants in the prolactin receptor and dopaminergic pathways previously associated with migraine and drug response., Stratified analyses of efficacy and safety outcomes by sex, menopausal status, aura, presence of dopaminergic symptoms, and number of prior preventive treatments., Estimation of cost per responder and cost per QALY gained. This analysis will be descriptive and exploratory.

Source: https://euclinicaltrials.eu/ctis-public/view/2025-522323-10-00